EU clinical trial 2022-500347-20-00: Safety and Tolerability of AC01 in patients with heart failure
Protocol code: AC01-01
Sponsor: Anacardio AB (Pharmaceutical company). Phase: Phase I and Phase II (Integrated)- Other. Countries: Sweden (ended), Italy (ended), Netherlands (ended).
Therapeutic area(s): Diseases [C] - Cardiovascular Diseases [C14]
Gender: Female, Male. Age: 18-64 years, 65+ years. Enrolment: 46.
Status: Ended. Start date (EU): 2023-02-23. End date (EU): 2025-10-13. End date: 2025-10-20. Decision date: 2022-10-28. Results received: No. Last updated: 2025-03-27.
Decision dates by country: IT: 2022-11-02, SE: 2022-10-28, NL: 2022-11-11

Condition(s): Heart Failure

Source: https://euclinicaltrials.eu/ctis-public/view/2022-500347-20-00